EU clinical trial 2024-515527-11-00: Ph 1 Study of ORIC-944 in Patients with Metastatic Prostate Cancer.
Protocol code: ORIC-944-01
Sponsor: ORIC Pharmaceuticals Inc. (Pharmaceutical company). Phase: Human Pharmacology (Phase I)- First administration to humans. Countries: Spain (ongoing, recruiting).
Therapeutic area(s): Diseases [C] - Neoplasms [C04]
Gender: Male. Age: 18-64 years, 65+ years. Enrolment: 48.
Status: Ongoing, recruiting. Start date (EU): 2025-03-20. Decision date: 2025-02-03. Results received: No. Last updated: 2026-07-14.
Decision dates by country: ES: 2025-04-11

Condition(s): Prostate cancer

Source: https://euclinicaltrials.eu/ctis-public/view/2024-515527-11-00